EU clinical trial 2023-508388-64-00: A study to learn how zilucoplan moves throughout the body over time when given in 2 different ways in healthy adults
Protocol code: DV0012
Sponsor: UCB Biopharma (Pharmaceutical company). Phase: Human Pharmacology (Phase I)- Bioequivalence Study. Countries: Netherlands (ended).
Therapeutic area(s): Phenomena and Processes [G] - Musculoskeletal and Neural Physiological Phenomena [G11]
Gender: Female, Male. Age: 18-64 years. Enrolment: 14.
Status: Ended. Start date (EU): 2024-08-05. End date (EU): 2024-11-26. Decision date: 2024-06-12. Results received: No. Last updated: 2024-12-03.

Condition(s): Healthy Volunteers

Source: https://euclinicaltrials.eu/ctis-public/view/2023-508388-64-00